EU clinical trial 2023-506602-39-00: A randomised, controlled trial to investigate the effect of a six-week intensified pharmacological treatment for schizophrenia compared to treatment as usual in subjects who had a first-time treatment failure on their first-line treatment.
Protocol code: INTENSIFY SZ
Sponsor: Universitair Medisch Centrum Utrecht (Hospital/Clinic/Other health care facility). Phase: Therapeutic use (Phase IV). Countries: Austria (authorised, recruitment pending), Germany (ongoing, recruiting), Spain (authorised, recruitment pending), Italy (ongoing, recruiting).
Therapeutic area(s): Psychiatry and Psychology [F] - Mental Disorders [F03]
Gender: Female, Male. Age: 18-64 years, 65+ years. Enrolment: 310.
Start date (EU): 2024-08-01. Decision date: 2023-12-20. Results received: No. Last updated: 2026-08-06.
Decision dates by country: AT: 2023-12-28, ES: 2024-01-08, IT: 2024-01-08, DE: 2023-12-20

Condition(s): schizophrenia, schizoaffective disorder, schizophrenifom disorder
Product: CHLORPROMAZINE, BREXPIPRAZOLE, HALOPERIDOL, RISPERIDONE, CLOTIAPINE, LURASIDONE, CLOZAPINE, SULPIRIDE, PALIPERIDONE, PERPHENAZINE, SERTINDOLE, FLUPENTIXOL, CARIPRAZINE, FLUPHENAZINE, ASENAPINE, ZIPRASIDONE, OLANZAPINE, LEVOMEPROMAZINE, AMISULPRIDE, ARIPIPRAZOLE, ZUCLOPENTHIXOL, QUETIAPINE, PROMAZINE

Primary endpoint: Mean change from baseline (visit 2) in symptom severity as measured by the PANSS total score at six weeks (visit 4) will be compared between the two treatment arms (EIPT vs. TAU. )
Endpoint(s): Change from baseline (visit 2) in PANSS subscale scores (positive, negative and general) at visit 4; EIPT vs TAU., 2.a. Change from baseline (visit 2) in the severity sub-score of the Clinical Global Impression Scale (CGI 1) at visit 4; EIPT vs TAU. 2.b. Improvement sub-score of the Clinical Global Impression Scale (CGI 1) at visit 4; EIPT vs TAU., Changes from baseline (visit 2) in total Hospital Anxiety and Depression Scale (HADS) total score and anxiety and depression subscales at visit 4; EIPT vs TAU., Change from baseline (visit 2) in quality of life and functioning measures (Q-LES-Q-SF, LAPS, QLS-100 and SDS) at visit 4; EIPT vs TAU., Changes from baseline (visit 2) on Trail Making Test, Digit Symbol Substitution Test, Rey Auditory Verbal Learning Test as well as the Perceived Deficits Questionnaire at visit 4; EIPT vs TAU., Presence of symptomatic remission at visit 4; EIPT vs TAU. Remission is defined as meeting the PANSS modified Andreasen criteria (Low scores (≤3) P1. Delusions; P3. Hallucinatory behavior; P2. Conceptual disorganization; N1. Blunted affect; N4. Passive/apathetic social withdrawal; N6. Lack of spontaneity and flow of conversation; G5. Mannerisms/posturing; G9. Unusual thought content., Presence of reported adverse events (related and unrelated to treatment) as measured through General Assessment of Side Effects Scale (GASE) and reported spontaneously througout the study; EIPT vs TAU., Concomitant medication use throughout the study; EIPT vs TAU., Premature treatment discontinuation before visit 4 and time to treatment discontinuation and reported reason of discontinuation; EIPT vs TAU., Changes on the Columbia-Suicide Severity Rating Scale (C-SSRS) throughout the study; EIPT vs TAU.

Source: https://euclinicaltrials.eu/ctis-public/view/2023-506602-39-00